EU clinical trial 2024-517475-20-00: Multicenter, randomized, open-label with blind evaluation, non-inferiority clinical trial, with parallel groups to evaluate the efficacy and safety of the topical application of Impetine® Gel (mupirocin 20 mg/g, Gel) compared with Bactroban® (mupirocin 20 mg/g, Ointment) for the treatment of impetigo in paediatric population
Protocol code: OP-IPTC02
Sponsor: Laboratorios Ojer Pharma S.L. (Pharmaceutical company). Phase: Therapeutic confirmatory (Phase III). Countries: Spain (ongoing, recruiting).
Therapeutic area(s): Diseases [C] - Bacterial Infections and Mycoses [C01]; Diseases [C] - Skin and Connective Tissue Diseases [C17]
Gender: Female, Male. Age: 0-17 years. Enrolment: 464.
Status: Ongoing, recruiting. Start date (EU): 2025-10-13. Decision date: 2025-06-27. Results received: No. Last updated: 2026-07-03.

Condition(s): Impetigo
Product: Impetine® 20mg/g Gel, Bactroban 20 mg/g pomada

Primary endpoint: Clinical cure at EOF – Visit 4 measured as the proportion of subjects with clinical cure based on SIRS according to the blinded assessor.
Endpoint(s): Clinical cure at EOT – Visit 3 measured as the proportion of subjects with clinical cure based on SIRS according to the blinded assessor., Clinical cure at EOT and EOF measured as the proportion of subjects with clinical cure based on SIRS according to the investigator., Total SIRS scores at EOT and EOF according to the blinded assessor., Total SIRS scores at EOT and EOF according to the investigator., Bacteriological cure at EOF., Treatment satisfaction at EOT., Incidence of adverse events.

Source: https://euclinicaltrials.eu/ctis-public/view/2024-517475-20-00